EU clinical trial 2024-514797-45-00: An Open-Label, Multicenter Study to Investigate the Safety, Tolerability, Pharmacokinetics and Pharmacodynamics of RO7248824 In Participants with Angelman Syndrome
Protocol code: BP41674
Sponsor: F. Hoffmann-La Roche AG (Pharmaceutical company). Phase: Human Pharmacology (Phase I)- Other. Countries: Netherlands (ended), Italy (ended), Spain (ended).
Therapeutic area(s): Diseases [C] - Nervous System Diseases [C10]
Gender: Female, Male. Age: 0-17 years. Enrolment: 28.
Status: Ended. Start date (EU): 2020-08-25. End date (EU): 2025-07-18. End date: 2025-07-31. Decision date: 2024-10-10. Results received: Yes. Last updated: 2024-12-11.
Decision dates by country: IT: 2024-12-02, ES: 2024-10-11, NL: 2024-10-10

Condition(s): Angelman Syndrome (AS)
Product: Rugonersen

Primary endpoint: 1. Frequency and severity of adverse events, serious adverse events, treatment discontinuations due to adverse events (MAD, LTE, OOE), 2. Frequency of abnormal laboratory findings (blood and cerebrospinal fluid [CSF]) (MAD, LTE, OOE), 3. Frequency of abnormal vital signs and ECG values (MAD, LTE), 4. Mean changes from baseline in vital signs (temperature, systolic and diastolic blood pressure, heartrate, respiratory rate) over time (MAD, LTE)
Endpoint(s): 1. Time to maximum concentration (Tmax) (MAD, LTE, OOE), 2. Maximum plasma concentration observed (Cmax) (MAD, LTE, OOE), 3. AUC from Time 0 to time of last sampling point or last quantifiable sample, whichever comes first (AUClast), AUC from Time 0 to infinity (AUCinf) (MAD, LTE, OOE)

Source: https://euclinicaltrials.eu/ctis-public/view/2024-514797-45-00